EU clinical trial 2024-520157-20-00: Effects of opioid-free multimodal anesthesia on functional neuroimaging and electroencephalogram
Protocol code: RESOFA
Sponsor: Consorci Mar Parc De Salut De Barcelona (Hospital/Clinic/Other health care facility). Phase: Human Pharmacology (Phase I)- Other. Countries: Spain (ongoing, recruiting).
Therapeutic area(s): Analytical, Diagnostic and Therapeutic Techniques and Equipment [E] - Anesthesia and Analgesia [E03]
Gender: Female, Male. Age: 18-64 years. Enrolment: 40.
Status: Ongoing, recruiting. Start date (EU): 2025-09-09. Decision date: 2025-03-31. Results received: No. Last updated: 2026-06-08.

Condition(s): healthy volunteers undergoing induced sedation

Source: https://euclinicaltrials.eu/ctis-public/view/2024-520157-20-00